EU clinical trial 2023-506156-25-00: A phase I study evaluating safety and efficacy of Hepatic Intra- Arterial administration of ipilimumab in combination with Intra- venous nivolumab for advanced Hepatocellular carcinoma (HIPANIV)
Protocol code: CSET N°2020/3138
Sponsor: Institut Gustave Roussy (Hospital/Clinic/Other health care facility). Phase: Phase I and Phase II (Integrated)- Other. Countries: France (ended).
Therapeutic area(s): Diseases [C] - Neoplasms [C04]
Gender: Female, Male. Age: 18-64 years, 65+ years. Enrolment: 30.
Status: Ended. Start date (EU): 2020-11-13. End date (EU): 2025-01-13. Decision date: 2024-11-08. Results received: No. Last updated: 2024-11-08.

Condition(s): Advanced hepatocellular carcinoma

Source: https://euclinicaltrials.eu/ctis-public/view/2023-506156-25-00